EU clinical trial 2024-514499-42-00: A Double-Blind, Randomized, Placebo and Active Controlled Study to Evaluate the Efficacy and Safety of Once Daily, Extended Release Levetiracetam as Add-on Therapy in Patients with Refractory Partial Onset Epilepsy.
Protocol code: NXPLEVE/24/P3-6
Sponsor: Neuraxpharm Pharmaceuticals S.L. (Pharmaceutical company). Phase: Therapeutic confirmatory (Phase III). Countries: Poland (ongoing, recruiting), Romania (ongoing, recruiting), Germany (authorised, recruiting), Czechia (ongoing, recruiting), Bulgaria (ongoing, recruiting), Italy (ongoing, recruiting), Spain (authorised, recruiting), Hungary (ongoing, recruiting), Greece (ongoing, recruiting).
Therapeutic area(s): Diseases [C] - Nervous System Diseases [C10]
Gender: Female, Male. Age: 0-17 years, 18-64 years, 65+ years. Enrolment: 134.
Start date (EU): 2025-03-12. Decision date: 2025-02-11. Results received: No. Last updated: 2026-07-24.
Decision dates by country: DE: 2025-02-18, BG: 2025-02-18, CZ: 2025-02-18, HU: 2025-02-18, IT: 2025-02-18, RO: 2025-02-14, ES: 2025-02-18, GR: 2025-10-08, PL: 2025-02-17

Condition(s): Refractory Partial Onset Epilepsy
Product: Keppra 500 mg film-coated tablets, Masked Keppra® placebo film-coated tablets (a placebo tablet inside a capsule), Levetiracetam XR, Levetiracetam prolonged-release placebo granules

Primary endpoint: Percent change from baseline* in FOS frequency per week over the 12 week double-blind period.
Endpoint(s): Change from baseline* in absolute FOS over the 12 week double-blind period., Proportion of subjects with at least 50% reduction from baseline* in total seizure frequency per week over the 12 week double-blind period., Proportion of subjects with at least 50% reduction from baseline* in total seizures over the 12 week double-blind period., Number of days free of FOS over the treatment period of 12 weeks., Response in Weekly FOS Frequency (Categorized Into 6 Categories According to Reduction) Over the Treatment Period of 12 Weeks)., Change in the Quality of Life in Epilepsy (QoLIE-31) scale score (patients ≥18 years) and QoLIE- AD-48 (age <18 years) over the study period., Improving medication compliance and patient satisfaction with the treatment over the study period.

Source: https://euclinicaltrials.eu/ctis-public/view/2024-514499-42-00